EU clinical trial 2022-502778-18-00: A randomized, double-blind, multicenter phase 3 study in patients with moderately to severely active ulcerative colitis (UC) to compare the efficacy, safety and immunogenicity of PB016 and Entyvio® for the induction and maintenance of clinical response and remission. (UCESIVE)
Protocol code: PB016-03-01
Sponsor: Polpharma Biologics S.A. (Pharmaceutical company). Phase: Therapeutic confirmatory (Phase III). Countries: Czechia (ended), Poland (ended), Romania (ended), Hungary (ended), Slovakia (ended), Latvia (ended), Bulgaria (ended).
Therapeutic area(s): Diseases [C] - Digestive System Diseases [C06]
Gender: Female, Male. Age: 18-64 years, 65+ years. Enrolment: 550.
Status: Ended. Start date (EU): 2023-11-17. End date (EU): 2026-04-01. End date: 2026-04-02. Decision date: 2023-06-14. Results received: No. Last updated: 2026-01-19.
Decision dates by country: BG: 2024-03-25, HU: 2023-06-19, SK: 2023-06-19, CZ: 2023-06-14, RO: 2023-06-19, PL: 2023-06-19, LV: 2023-11-09

Condition(s): ulcerative colitis
Product: VEDOLIZUMAB, Entyvio 300 mg powder for concentrate for solution for infusion

Primary endpoint: Clinical response rate, defined as the proportion of patients with a reduction in complete Mayo score of ≥3 points and ≥30% from Baseline* with an accompanying decrease in rectal bleeding (RB) sub-score of ≥1 point or absolute RB sub-score of ≤1 point, at Week 6. *Visit 1 (Day 0) is to be considered Baseline unless the assessment is not performed at Visit 1. In such cases, the Screening assessment is to be considered Baseline.
Endpoint(s): 1. Clinical response rate at Week 52, 2. Change from Baseline* in partial Mayo score at Weeks 2, 6, 14, 22, 30, 38, 46, and 52. *Visit 1 (Day 0) is to be considered Baseline unless the assessment is not performed at Visit 1. In such cases, the Screening assessment is to be considered Baseline., 3. Clinical remission rate, defined as the proportion of patients with complete Mayo score of ≤2 points and no individual sub-score >1 point, at Weeks 6 and 52, 4. Mucosal healing rate, defined as the proportion of patients with a Mayo endoscopic sub-score of ≤1 point, at Weeks 6 and 52, 5. Corticosteroid-free remission rate, defined as the proportion of patients using oral corticosteroids at Baseline* who have discontinued corticosteroids and are in clinical remission at Week 52. *Visit 1 (Day 0) is to be considered Baseline unless the assessment is not performed at Visit 1. In such cases, the Screening assessment is to be considered Baseline., 6. Change from Baseline* in fecal calprotectin at Weeks 6, 22, and 52; Change from Baseline* in blood C-reactive protein (CRP) at Weeks 6, 22, and 52. *Visit 1 (Day 0) is to be considered Baseline unless the assessment is not performed at Visit 1. In such cases, the Screening assessment is to be considered Baseline., 7. Vedolizumab (Ctrough) levels at Baseline*, Weeks 2, 6, 14, 22, 30, 38, and 52. *Visit 1 (Day 0) is to be considered Baseline unless the assessment is not performed at Visit 1. In such cases, the Screening assessment is to be considered Baseline., 8. Number of patients with adverse events (AEs) and serious adverse events (SAEs); Number of patients discontinuing treatment due to AEs or SAEs, 9. Number of patients with anti-drug antibodies (ADAs) and neutralizing antibodies (NAb) at Baseline* and at Weeks 2, 6, 14, 30, and 52. *Visit 1 (Day 0) is to be considered Baseline unless the assessment is not performed at Visit 1. In such cases, the Screening assessment is to be considered Baseline.

Source: https://euclinicaltrials.eu/ctis-public/view/2022-502778-18-00